EU clinical trial 2025-522088-13-00: The DALBA-study Introduction of the antibiotic dalbavancin in orthopaedic surgery – an evaluation of: • Health economic costs • Patient-reported outcomes on quality of life • Local bone and soft tissue concentrations • Effect on the gut microbiome A randomised controlled study of dalbavancin versus standard antibiotic treatment of Gram-positive periprosthetic joint infections.
Protocol code: 32522
Sponsor: Region Midtjylland (Hospital/Clinic/Other health care facility). Phase: Therapeutic use (Phase IV). Countries: Denmark (ongoing, recruiting).
Therapeutic area(s): Diseases [C] - Bacterial Infections and Mycoses [C01]
Gender: Female, Male. Age: 18-64 years, 65+ years. Enrolment: 50.
Status: Ongoing, recruiting. Start date (EU): 2025-12-12. Decision date: 2025-10-02. Results received: No. Last updated: 2025-12-05.

Condition(s): Periprosthetic joint infection
Product: FLUCLOXACILLIN, LINEZOLID, CLOXACILLIN, AMOXICILLIN, DICLOXACILLIN, SULFAMETHOXAZOLE AND TRIMETHOPRIM, LEVOFLOXACIN, MOXIFLOXACIN, CLINDAMYCIN, FUSIDIC ACID, CEFTRIAXONE, BENZYLPENICILLIN, RIFAMPICIN, GENTAMICIN, DALBAVANCIN, VANCOMYCIN

Primary endpoint: Cost-utility analysis during antibiotic treatment (intention-to-treat): Absolute treatment costs during the acute treatment period of 6 or 12 weeks of antibiotics in the two treatment groups, assessed in relation to quality-adjusted life years (QALYs).
Endpoint(s): Cost-utility analysis after one-year of follow-up (per protocol): Long-term health economics and patient-experienced quality of life, incorporating long-term effects and any late complications or recurrence within the first year., Physical activity: Average daily activity during the treatment period (6 or 12 weeks), recorded using an activity tracker., Tissue concentration: Standard pharmacokinetic parameters (e.g., AUC/MIC, T>MIC, AUC, T½, Cmax, Tmax) in bone tissue, subcutaneous tissue, and plasma., Gut response: Gut microbiome diversity profile and resistome, including AMR genes., Immune response: Standard histological examination of HE stains with quantification of the infiltration of neutrophil granulocytes, macrophages, and lymphocytes. In addition, histological identification of specific genes and proteins involved in inflammatory and immune-regulatory pathways.

Source: https://euclinicaltrials.eu/ctis-public/view/2025-522088-13-00